EU clinical trial 2024-519346-75-00: Radiometabolic Therapy (RMT) with 177Lu PSMA in PSMA PET/CT positive advanced/metastatic tumours: a basket trial (LUBASKET)
Protocol code: IRST100.58
Sponsor: Istituto Romagnolo Per Lo Studio Dei Tumori Dino Amadori IRST S.r.l. (Hospital/Clinic/Other health care facility). Phase: Therapeutic exploratory (Phase II). Countries: Italy (ongoing, recruitment ended).
Therapeutic area(s): Diseases [C] - Neoplasms [C04]
Gender: Female, Male. Age: 18-64 years, 65+ years. Enrolment: 83.
Status: Ongoing, recruitment ended. Start date (EU): 2023-05-25. Decision date: 2025-01-15. Results received: No. Last updated: 2025-01-15.

Condition(s): PSMA PET/CT positive advanced/metastatic tumours
Product: 177Lu-PSMA I&T_IRSTIRCCS

Primary endpoint: DCR, defined as the percentage of patients who have achieved complete response, partial response, stable disease (according to RECIST 1.1), or no progression of disease for patients with prostate cancer (according to PCWG3 criteria), at the 1st planned evaluation. Safety, evaluated according to version 5.0 CTC-AE. Safety is defined as the percentage of patients who experience acute toxicity from the 1st treatment until 30 days after the last treatment cycle.
Endpoint(s): PFS is defined as the time from the start treatment date to the date of first observation of documented disease progression (according to RECIST 1.1 or PCWG3 criteria for prostate cancer patients) or death due to any cause. Patients without tumor progression at the time of analysis will be censored at their last date of tumor evaluation., Overall survival is defined as the time from the therapy start to the date of death due to any cause or the date of last contact (censored observation) at the date of data cut-off., The late toxicity is the toxicity that occurred after 30 days from the last treatment administration up to 6 months., PET/CT response is based on SUV. The dosimetry objective is evaluated through pharmacokinetic measures, biodistribution activity and absorbed dose to salivary gland (critical organ), kidneys, bone marrow and tumour.

Source: https://euclinicaltrials.eu/ctis-public/view/2024-519346-75-00